EU clinical trial 2024-517710-15-00: Preoperative use of Romiplostim in thrombocytopenic patients undergoing cardiac surgery. A Phase 3, multicenter randomized double-blinded controlled against placebo study
Protocol code: RC24_0458
Sponsor: Centre Hospitalier Universitaire De Nantes (Hospital/Clinic/Other health care facility). Phase: Therapeutic exploratory (Phase II). Countries: France (ongoing, recruiting).
Therapeutic area(s): Analytical,Diagnostic,Therapeutic Techniques and Equipment [E]-Surgical Procedures, Operative [E04]
Gender: Female, Male. Age: 18-64 years, 65+ years. Enrolment: 136.
Status: Ongoing, recruiting. Start date (EU): 2026-07-16. Decision date: 2025-10-22. Results received: No. Last updated: 2026-07-09.

Condition(s): thrombocytopenic patients undergoing cardiac surgery
Product: Nplate 250 micrograms powder for solution for injection, Nplate 250 micrograms powder for solution for injection, CHLORURE DE SODIUM PROAMP 0,9 %, solution injectable

Primary endpoint: Lowest platelet count measured between the end of CEC and the 7th postoperative day with D0 = day of surgery. This criterion will take into account any tests performed at the hospital or in the city (if the patient is discharged from the hospital before the 7th postoperative day).
Endpoint(s): Transfusion of platelet concentrate (PC) (yes/no and number) - Per-operatively up to 24th hour, per-operatively up to 7th day, per-operatively up to 28th day, Transfusion of red blood cell concentrate (RGC) (yes/no and number) - Per-operatively up to 24th hour, per-operatively up to 7th day, per-operatively up to 28th day, Transfusion of fresh frozen plasma (FFP) (yes/no and number) - Per-operatively up to 24th hour, per-operatively up to 7th day, per-operatively up to 28th day, Administration of blood-derived drugs: fibrinogen, prothrombin complex concentrates, recombinant activated factor VII - Per-operatively up to 24th hour, per-operatively up to 7th day, per-operatively up to 28th day, Lowest platelet count in the first 28 days post-operatively, Highest platelet count in the first 7 days and in the first 28 days post-operatively, Lowest haemoglobin in the first 7 days and in the first 28 days post-operatively, Post-operative bleeding volume: - From sternal closure to 12th post-operative hour, - From discharge to 24th post-operative hour - From the 24th postoperative hour to drain removal, - Classification of bleeding according to UDPB classes,65 - Surgical revision (including sternal reopening), - Intraoperative blood recovery (volume treated and volume restored)., Postoperative morbidity and mortality: - Intraoperative and 24h bleeding/hemorrhagic events - Duration of mechanical ventilation in intensive care unit (in hours), - Bleeding event within 3 months post-op: - Venous and arterial thromboembolic events within 3 months post-operatively - Infection within 3 months : - Organ dysfunction, - Length of stay in intensive care unit, - Length of hospital stay, - Mortality at D28 post-op.

Source: https://euclinicaltrials.eu/ctis-public/view/2024-517710-15-00